EU clinical trial 2024-515135-29-00: Treatment of patients with advanced breast cancer harboring TP53 mutations with dose-dense cyclophosphamide - The p53 breast cancer trial
Protocol code: P53
Sponsor: Helse Bergen HF (Hospital/Clinic/Other health care facility). Phase: Therapeutic exploratory (Phase II). Countries: Norway (ongoing, recruitment ended).
Therapeutic area(s): Diseases [C] - Neoplasms [C04]
Gender: Female. Age: 18-64 years, 65+ years. Enrolment: 63.
Status: Ongoing, recruitment ended. Start date (EU): 2024-10-12. Decision date: 2024-10-11. Results received: No. Last updated: 2024-10-11.

Condition(s): breast cancer
Product: Cyclophosphamid beta 1000 mg/2 ml Konzentrat zur Herstellung einer Injektions-/Infusionslösung

Primary endpoint: Objective response rate
Endpoint(s): pCR, Clinical benefit rate, Recurrence-free survival, safety and tolerability

Source: https://euclinicaltrials.eu/ctis-public/view/2024-515135-29-00